EU clinical trial 2022-502087-21-00: A Phase 1/2 Study of the Safety, Pharmacokinetics and Anti-Tumor Activity of the Oral KIT Inhibitor THE-630 in Patients with Advanced Gastrointestinal Stromal Tumors (GIST)
Protocol code: THE630-21-101
Sponsor: Theseus Pharmaceuticals Inc. (Pharmaceutical company). Phase: Phase I and Phase II (Integrated)- First administration to humans. Countries: Spain (ended), France (ended).
Therapeutic area(s): Diseases [C] - Neoplasms [C04]
Gender: Female, Male. Age: 18-64 years, 65+ years. Enrolment: 37.
Status: Ended. End date (EU): 2023-07-13. End date: 2024-02-02. Decision date: 2023-06-02. Results received: Yes. Last updated: 2023-06-05.
Decision dates by country: FR: 2023-06-05, ES: 2023-06-02

Condition(s): Gastrointestinal Stromal Tumors (GIST)
Product: THE-630, THE-630, THE-630, THE-630

Primary endpoint: Dose Escalation (Phase 1): Safety profile of oral THE-630, including identification of DLTs and MTD, and determination of the RP2D., Expansion (Phase 2): Confirmed ORR, according to modified RECIST 1.1 for patients with GIST.
Endpoint(s): Dose Escalation (Phase 1): Plasma PK parameters of THE-630 and its active metabolite THE-973 after single oral dose and at steady state after multiple oral doses., Dose Escalation (Phase 1): Efficacy assessments, according to modified RECIST 1.1 for patients with GIST including: confirmed ORR, best overall response, best target lesion response, time to response, DOR, DCR, CBR at 16 weeks, PFS, and OS., Expansion (Phase 2): Efficacy assessments, according to modified RECIST 1.1 for patients with GIST, including: DOR, best overall response, best target lesion response, time to response, DCR, CBR at 16 weeks, PFS, and OS., Expansion (Phase 2): Safety profile of oral THE-630., Expansion (Phase 2): Plasma PK parameters of THE-630 and its active metabolite THE-973, after a single oral dose and at steady state after multiple oral doses.

Source: https://euclinicaltrials.eu/ctis-public/view/2022-502087-21-00